EU clinical trial 2024-512038-13-00: C4221016 - A Phase 3, Randomized, Double-Blind Study of Encorafenib and Binimetinib Plus Pembrolizumab Versus Placebo Plus Pembrolizumab in Participants with BRAF V600E/K Mutation-Positive Metastatic or Unresectable Locally Advanced Melanoma
Protocol code: C4221016
Sponsor: Pfizer Inc. (Pharmaceutical company). Phase: Therapeutic confirmatory (Phase III). Countries: Italy (ongoing, recruitment ended), Belgium (ended), Poland (ended), Germany (ended), Hungary (ongoing, recruitment ended), Czechia (ongoing, recruitment ended), Spain (ended), Finland (ended), Slovakia (ended), Greece (ongoing, recruitment ended), Bulgaria (ended).
Therapeutic area(s): Diseases [C] - Neoplasms [C04]
Gender: Female, Male. Age: 18-64 years, 65+ years. Enrolment: 161.
Start date (EU): 2021-09-16. Decision date: 2024-05-29. Results received: No. Last updated: 2026-06-25.
Decision dates by country: PL: 2024-05-31, HU: 2024-06-04, SK: 2024-05-29, BE: 2024-05-29, FI: 2024-05-29, GR: 2024-08-19, DE: 2024-06-03, BG: 2024-07-01, IT: 2024-06-03, ES: 2024-05-29, CZ: 2024-05-29

Condition(s): Metastatic or unresectable locally advanced BRAF V600E/K mutation positive melanoma
Product: Encorafenib Pacebo, Binimetinib placebo, BINIMETINIB, ENCORAFENIB, KEYTRUDA 25 mg/mL concentrate for solution for infusion

Primary endpoint: Safety Lead-In: Incidence of DLTs., Randominzed Phase 3: OR, defined as confirmed BOR of either CR or PR, as determined by BICR assessment per RECIST v1.1 from randomization to the earliest of PD, start of subsequent anticancer therapy, or death due to any cause
Endpoint(s): 1. Safety Lead-In: Incidence and severity of AEs graded according to the NCI CTCAE v4.03* and changes in clinical laboratory parameters, vital signs, and cardiac assessments., 2. Safety Lead-In: OR, PFS, DC, TTR, 3. Safety Lead-In: Plasma concentration-time profiles and PK parameter estimates for encorafenib and binimetinib., 4. Randomized Phase 3: PFS, defined as the time from the date of randomization to the date of first documented disease progression, as determined by BICR assessment per RECIST v1.1, or death due to any cause, whichever occurs first.

Source: https://euclinicaltrials.eu/ctis-public/view/2024-512038-13-00